EU clinical trial 2024-518334-88-00: Reducing Non-Alcoholic Steatohepatitis
Protocol code: RedNASH2023
Sponsor: Ustredni Vojenska Nemocnice Vojenska Fakultni Nemocnice Praha (Hospital/Clinic/Other health care facility). Phase: Therapeutic use (Phase IV). Countries: Czechia (authorised, recruitment pending).
Therapeutic area(s): Diseases [C] - Nutritional and Metabolic Diseases [C18]
Gender: Female, Male. Age: 18-64 years, 65+ years. Enrolment: 20.
Status: Authorised, recruitment pending. Decision date: 2024-10-08. Results received: No. Last updated: 2024-10-08.

Condition(s): Metabolic dysfunction-associated steatohepatitis
Product: Jardiance 10 mg film-coated tablets

Primary endpoint: Decrease of a histological score of NASH
Endpoint(s): Decrease of fibrosis stage assessed by non-invasive liver elastography. Improvement of laboratory results and anthropometric data

Source: https://euclinicaltrials.eu/ctis-public/view/2024-518334-88-00